EU clinical trial 2023-505512-37-00: A Randomized, Multi-Center Phase III Trial comparing two conditioning regimens (CloFluBu and BuCyMel) in children with Acute Myeloid Leukemia undergoing allogeneic stem cell transplantation.
Sponsor: Vaestra Goetalandsregionen (Hospital/Clinic/Other health care facility). Phase: Therapeutic confirmatory (Phase III). Countries: Finland (ongoing, recruiting), Sweden (ongoing, recruiting), Denmark (ongoing, recruiting), Netherlands (ongoing, recruiting), Norway (ongoing, recruiting), Belgium (ongoing, recruiting), Lithuania (authorised, recruitment pending).
Therapeutic area(s): Diseases [C] - Hemic and Lymphatic Diseases [C15]
Gender: Female, Male. Age: 0-17 years. Enrolment: 113.
Start date (EU): 2022-06-07. Decision date: 2023-11-07. Results received: No. Last updated: 2026-06-05.
Decision dates by country: SE: 2023-11-07, DK: 2023-11-13, NO: 2023-11-16, BE: 2025-05-09, FI: 2023-11-07, NL: 2023-11-09, LT: 2026-06-05

Condition(s): Acute Myeoloid Leukemia
Product: Fludarabin Actavis 25 mg/ml koncentrat till injektions-/infusionsvätska, lösning, Evoltra 1 mg/ml concentrate for solution for infusion, Sendoxan pulver till injektionsvätska, lösning, Thymoglobuline 25 mg powder for solution for infusion, Busulfan Fresenius Kabi 6 mg/ml concentrate for solution for infusion, Alkeran 50 mg pulver och vätska till injektionsvätska, lösning, Grafalon 20 mg/ml concentrate for solution for infusion

Primary endpoint: The primary endpoint is the 2-year acute grade III to IV-free, chronic non-limited GVHD-free, relapse free survival, GvHD III-IV, chronic non-limited GvHD, relapse, death) or last follow-up
Endpoint(s): - Disease free Survival (DFS, - Overall Survival (OS), - Cumulative incidence of relapse (CIR, - Transplant-related Mortality (TRM), - Hematologic Recovery, - Graft Failure (GF), - Immune Reconstitution, - Chronic GVHD, -Infections, - Toxicity, - Transplant-associated hormonal and gonadal late effect, - Nutritional status

Source: https://euclinicaltrials.eu/ctis-public/view/2023-505512-37-00